EU clinical trial 2024-516868-28-00: Ponatinib for the management of minimal residual disease (MRD) and hematologic relapsein adult Ph+ acute lymphoblastic leukemia (Ph+ ALL) patients.ALL2620
Protocol code: ALL2620
Sponsor: Fondazione Gimema Franco Mandelli Onlus (Patient organisation/association). Phase: Therapeutic exploratory (Phase II). Countries: Italy (ended).
Therapeutic area(s): Diseases [C] - Hemic and Lymphatic Diseases [C15]
Gender: Female, Male. Age: 18-64 years, 65+ years. Enrolment: 67.
Status: Ended. Start date (EU): 2021-05-04. End date (EU): 2025-09-08. Decision date: 2024-09-18. Results received: No. Last updated: 2024-09-18.

Condition(s): Ph+ Acute Lymphoblastic Leukemia
Product: CYTARABINE, METHYLPREDNISOLONE, Iclusig 15 mg film-coated tablets, METHOTREXATE, VINCRISTINE, PONATINIB, PREDNISONE

Primary endpoint: The primary endpoint is the rate of patients who achieve a MRD negativity/MRD reduction following treatment with either Ponatinib alone or in combination with systemic chemotherapy after 3 months of treatment.
Endpoint(s): Duration of CMR, if applicable., Rate of patients who achieve an hematologic remission in patients treated for an hematologic and extra-hematoloigc relapse and for a refractory disease., The best molecular response achieved during the study., Safety profile in terms of incidence of grade >3 CTC-NCI side effects and toxicities (AE/SAEs)., Mutational analysis in terms of occurrence, type and number of BCR-ABL1 kinase domain mutations., Correlation between the achievement and duration of CMR (or MRD reduction) with the type of fusion protein (e.g. p190 or p210) and the potential occurrence of mutations, as well as with additional genomic lesions, DFS at 24 months., OS at 24 months, CIR at 24 months., Role of clinical and biological assessment at baseline, type of fusion protein (p190 vs p210) and presence of additional genomic lesions and mutations, duration on CMR, OS and DFS.

Source: https://euclinicaltrials.eu/ctis-public/view/2024-516868-28-00